EU clinical trial 2023-505026-34-00: A first human dose study to assess the safety, tolerability, pharmacokinetics and target engagement of single doses of NNC6022-0001 in healthy adults
Protocol code: NN6022-7683
Sponsor: Novo Nordisk A/S (Pharmaceutical company). Phase: Human Pharmacology (Phase I)- First administration to humans. Countries: Netherlands (ended).
Therapeutic area(s): Diseases [C] - Male Urogenital Diseases [C12]; Diseases [C] - Cardiovascular Diseases [C14]; Diseases [C] - Digestive System Diseases [C06]
Gender: Female, Male. Age: 18-64 years. Enrolment: 56.
Status: Ended. Start date (EU): 2024-03-26. End date (EU): 2025-02-17. Decision date: 2024-03-11. Results received: No. Last updated: 2025-07-09.
Decision dates by country: NL: 2024-03-13

Condition(s): Cardiometabolic diseases

Source: https://euclinicaltrials.eu/ctis-public/view/2023-505026-34-00